EU clinical trial 2024-513530-37-00: Comparison of an inhaled sedation strategy with an intravenous sedation strategy in intensive care patients treated with invasive mechanical ventilation: INASED study
Protocol code: 29BRC19.0280
Sponsor: Centre Hospitalier Regional Et Universitaire De Brest (Hospital/Clinic/Other health care facility). Phase: Therapeutic confirmatory (Phase III). Countries: France (ongoing, recruitment ended).
Therapeutic area(s): Diseases [C] - Nervous System Diseases [C10]
Gender: Female, Male. Age: 18-64 years, 65+ years. Enrolment: 250.
Status: Ongoing, recruitment ended. Start date (EU): 2024-08-09. Decision date: 2024-08-09. Results received: No. Last updated: 2026-07-16.

Condition(s): Delirium
Product: Propofol Baxter 10 mg/mL Emulsion zur Injektion/Infusion, SUFENTANIL, ISOFLURANE BELAMONT, liquide pour inhalation par vapeur

Primary endpoint: Occurrence (yes/no) of delirium in intensive care unit
Endpoint(s): ICU mortality, D28 mortality, - Length of stay in intensive care, - Number of days living without mechanical ventilation in intensive care at D28, - CAM-ICU scale (2 times/day), - The quality of sedation is defined by: compliance (yes/no) with the sedation target (sedation score set as the target when prescribing), - Need for additional medication to alleviate agitation (yes/no, and if yes neuroleptic, benzodiazepine, dexmedetomidine), - Need for additional physical restraint to alleviate a state of agitation (yes/no), - Number of accidental removals by the patient of intubation tubes, vascular access tubes, nasogastric tubes and urinary catheters, based on the number of days in intensive care., - Number of self- or hetero-aggressive acts per number of days in intensive care, - Average hospital costs per patient, - Daily and cumulative dose of sedative, - Cognitive consequences will be assessed. Calculation of CDR and IQCODE scores. Cognitive, psychological and quality of life assessment at 3 and 12 months.

Source: https://euclinicaltrials.eu/ctis-public/view/2024-513530-37-00